EU clinical trial 2023-504654-35-00: Prophylactic Treatment of Graves Ophthalmopathy (GO) in Newly Diagnosed Graves' Disease (GD) with Atorvastatin (ATORGO)
Sponsor: Region Skane (Hospital/Clinic/Other health care facility). Phase: Therapeutic exploratory (Phase II). Countries: Sweden (authorised, recruitment pending).
Therapeutic area(s): Diseases [C] - Hormonal diseases [C19]; Diseases [C] - Eye Diseases [C11]; Diseases [C] - Immune System Diseases [C20]
Gender: Female, Male. Age: 18-64 years, 65+ years. Enrolment: 554.
Status: Authorised, recruitment pending. Decision date: 2026-02-04. Results received: No. Last updated: 2026-02-04.

Condition(s): Graves Ofthalmopathy
Product: Atorvastatin Viatris 40 mg Filmtabletten

Primary endpoint: The proportion of patients developing active GO after 12 months, defined as a Clinical Activity Score (CAS) ≥3. CAS is a standardized method for assessing the activity of GO.
Endpoint(s): Proportion of patients developing clinical GO at 3, 6, 9, 15, and 18 months., Time from GD diagnosis to GO onset., Highest CAS recorded during the study period., Proportion of patients requiring interventions such as corticosteroids, orbital irradiation, or biologics (e.g., rituximab or teprotumumab)., Change in quality-of-life scores as measured by validated tools, including GO-QoL and Thyr-Pro questionnaires, at baseline, 12 months, and 18 months., Levels of TSH-receptor antibodies (TRAb) at 12 and 18 months, Identification of new GO-related biomarkers using proteomics and microarray analysis., Genetic differences between responders and non-responders to atorvastatin, identified via genome-wide association studies (GWAS) and analyses of relevant single nucleotide polymorphisms (SNPs).

Source: https://euclinicaltrials.eu/ctis-public/view/2023-504654-35-00